EU clinical trial 2024-516076-15-00: Continous fentanyl infusion in newborns with hypoxic ischemic encephalopathy treated with therapeutic hypothermia: pharmacokinetics study
Protocol code: FentanylTH
Sponsor: Azienda Ospedaliero Universitaria Di Modena (Hospital/Clinic/Other health care facility). Phase: Human Pharmacology (Phase I)- Other. Countries: Italy (authorised, recruitment pending).
Therapeutic area(s): Diseases [C] - Nervous System Diseases [C10]
Gender: Female, Male. Age: 0-17 years. Enrolment: 20.
Status: Authorised, recruitment pending. Decision date: 2024-08-05. Results received: No. Last updated: 2024-08-05.

Condition(s): Infants with perinatal asphyxiation and indication to hypothermic treatment with analgo-sedation performed with fentanyl
Product: FENTANYL

Primary endpoint: To evaluate pharmacokinetics of Fentanyl in asphyxiated infants treated with hypothermia, in a standard regimen of Fentanyl administration. Drug plasma concentrations at zero-time, within 30 min of the administration of the starting bolus, after 24-48-72-96 hours infusion will be assessed. Maximun- minimun concentration (Cmax-min) and clearance of drug will be determined.
Endpoint(s): To evaluate the safety of the Fentanyl regimen (load of 2 mcg/Kg of Fentanyl followed by a continuous infusion of Fentanyl at dosage of 1 mcg/kg/h for TH and heating fase) by recording drug side effect

Source: https://euclinicaltrials.eu/ctis-public/view/2024-516076-15-00